EU clinical trial 2022-501176-26-00: A Phase 3, Randomized, Double-Blind, Parallel-Group, Placebo-Controlled Study to Demonstrate the Efficacy and Safety of Milvexian, an Oral Factor XIa Inhibitor, for Stroke Prevention after an Acute Ischemic Stroke or High-Risk Transient Ischemic Attack
Protocol code: 70033093STR3001
Sponsor: Janssen - Cilag International (Pharmaceutical company). Phase: Therapeutic confirmatory (Phase III). Countries: Belgium (ongoing, recruitment ended), Czechia (ongoing, recruitment ended), Poland (ongoing, recruitment ended), France (ongoing, recruitment ended), Finland (ongoing, recruitment ended), Portugal (ongoing, recruitment ended), Netherlands (ongoing, recruitment ended), Lithuania (ongoing, recruitment ended), Denmark (ongoing, recruitment ended), Slovakia (ongoing, recruitment ended), Greece (ongoing, recruitment ended), Germany (ongoing, recruitment ended), Latvia (ongoing, recruitment ended), Croatia (ongoing, recruitment ended), Romania (ongoing, recruitment ended), Estonia (ongoing, recruitment ended), Hungary (ongoing, recruitment ended), Bulgaria (ongoing, recruitment ended), Austria (ongoing, recruitment ended), Italy (ongoing, recruitment ended), Spain (ongoing, recruitment ended), Sweden (ongoing, recruitment ended).
Therapeutic area(s): Diseases [C] - Cardiovascular Diseases [C14]
Gender: Female, Male. Age: 18-64 years, 65+ years. Enrolment: 5504.
Status: Ongoing, recruitment ended. Start date (EU): 2023-08-04. Decision date: 2023-06-29. Results received: No. Last updated: 2026-08-04.
Decision dates by country: AT: 2023-07-12, FI: 2023-07-04, CZ: 2023-07-03, BG: 2023-07-04, GR: 2023-07-10, PL: 2023-07-04, NL: 2023-07-10, HR: 2023-07-04, EE: 2023-07-07, LV: 2023-07-04, ES: 2023-07-10, BE: 2023-06-30, DK: 2023-06-30, FR: 2023-06-30, HU: 2023-07-10, IT: 2023-07-10, LT: 2023-07-10, PT: 2023-07-10, RO: 2023-07-04, SE: 2023-07-03, SK: 2023-07-03, DE: 2023-07-03

Condition(s): Acute Ischemic Stroke and High-Risk Transient Ischemic Attack
Product: ACETYLSALICYLIC ACID, Milvexian matching placebo, CLOPIDOGREL, JNJ-70033093

Primary endpoint: Time to first occurrence of ischemic stroke
Endpoint(s): Time to first occurrence of any component of the composite of CVD, MI, or ischemic stroke, Time to first occurrence of ischemic stroke in the first 90 days, Time to first occurrence of any component of MAVE (ie, composite of CVD, MI, ischemic stroke, MALE, symptomatic PE or DVT)

Source: https://euclinicaltrials.eu/ctis-public/view/2022-501176-26-00